EU clinical trial 2025-522673-11-00: Single-center phase I/IIa study of infusion of autologous peripheral blood T cells expanded and genetically modified by Sleeping Beauty family transposons to express a chimeric antigen receptor with anti-CD19 specificity conjugated with the 4-1BB costimulatory region and CD3z and huEGFRt signal transmission (TranspoCART19) in patients with CD19+ acute lymphoblastic leukemia resistant or refractory to treatment
Protocol code: Transpocall19
Sponsor: Clinica Universidad De Navarra (Hospital/Clinic/Other health care facility). Phase: Phase I and Phase II (Integrated)- Other. Countries: Spain (ongoing, recruiting).
Therapeutic area(s): Diseases [C] - Hemic and Lymphatic Diseases [C15]
Gender: Female, Male. Age: 0-17 years, 18-64 years, 65+ years. Enrolment: 24.
Status: Ongoing, recruiting. Start date (EU): 2026-03-17. Decision date: 2026-01-02. Results received: No. Last updated: 2026-05-22.

Condition(s): refractory or resistant CD19+ acute lymphoblastic leukemia
Product: TranspoCART19

Primary endpoint: To determine the maximum tolerated dose and evaluate the safety of TranspoCART19 cell infusion., To determine the efficacy of TranspoCART19 cell infusion
Endpoint(s): Toxicity assessment at 3 months and 1 year, defined as the number of grade II-IV adverse events using the CTC (Common Toxicity Criteria) version 5.0 (Annex 4) and the ASTCT classification., Treatment-related mortality (TRM) at 1, 3, and 1 year, defined as any death not directly caused by leukemia. For the purpose of estimating TRM, disease relapse or progression will be considered a competing event., Progression-free survival (PFS) at six months and one year after the procedure, defined as the time between TranspoCART19 infusion and disease progression or death. Patients alive and in complete remission will be censored at the time of last follow-up., Overall survival (OS) at one year after infusion, defined as the time between TranspoCART19 infusion and the patient's death from any cause. Surviving patients will be censored at the time of last follow-up., Response rate (overall and complete) at three months and one year., Best response rate achieved during the first 3 months of follow-up after administration of the first fraction of TranspoCART19.

Source: https://euclinicaltrials.eu/ctis-public/view/2025-522673-11-00